EU clinical trial 2024-513521-23-00: C3431004/MDV3100-13: A Phase 3, Randomized, Efficacy and Safety Study of Enzalutamide Plus Leuprolide, Enzalutamide Monotherapy, and Placebo Plus Leuprolide in Men With High-Risk Nonmetastatic Prostate Cancer Progressing After Definitive Therapy.
Protocol code: C3431004/MDV3100-13
Sponsor: Medivation Inc. (Pharmaceutical company). Phase: Therapeutic confirmatory (Phase III). Countries: Poland (ended), Slovakia (ongoing, recruitment ended), Sweden (ongoing, recruitment ended), France (ended), Italy (ongoing, recruitment ended), Austria (ended), Spain (ongoing, recruitment ended), Finland (ongoing, recruitment ended), Denmark (ended), Netherlands (ongoing, recruitment ended).
Therapeutic area(s): Diseases [C] - Neoplasms [C04]
Gender: Male. Age: 18-64 years, 65+ years. Enrolment: 366.
Start date (EU): 2015-08-19. Decision date: 2024-07-19. Results received: No. Last updated: 2025-12-12.
Decision dates by country: DK: 2024-07-25, AT: 2024-07-23, IT: 2024-07-31, SK: 2024-07-19, PL: 2024-08-30, SE: 2024-07-22, FR: 2024-08-27, NL: 2024-07-23, ES: 2024-07-19, FI: 2024-07-19

Condition(s): Prostate Cancer
Product: LEUPRORELIN ACETATE, Xtandi - 40 mg soft capsules, Placebo for Enzalutamide 40 mg soft gelatin capsule

Primary endpoint: To evaluate efficacy of the combination of enzalutamide plus leuprolide versus placebo plus leuprolide, as measured by MFS.
Endpoint(s): Time to PSA progression: Time to first use of new antineoplastic therapy; Overall survival., To evaluate efficacy, as measured by MFS between enzalutamide monotherapy versus placebo plus leuprolide.

Source: https://euclinicaltrials.eu/ctis-public/view/2024-513521-23-00